EU clinical trial 2023-506457-38-00: A Phase III, Randomised, Double-Blind, Study to Assess the Efficacy, Safety and Tolerability of Baxdrostat in Combination with Dapagliflozin Compared with Dapagliflozin Alone on Chronic Kidney Disease (CKD) Progression in Participants with CKD and High Blood Pressure
Protocol code: D6972C00003
Sponsor: Astrazeneca AB (Pharmaceutical company). Phase: Therapeutic confirmatory (Phase III). Countries: Belgium (ongoing, recruitment ended), Greece (ongoing, recruitment ended), Germany (ongoing, recruitment ended), Denmark (ongoing, recruitment ended), Bulgaria (ongoing, recruitment ended), Italy (ongoing, recruitment ended), Slovakia (ongoing, recruitment ended), Romania (ongoing, recruitment ended), Czechia (ongoing, recruitment ended), Spain (ongoing, recruitment ended), Hungary (ongoing, recruitment ended), Poland (ongoing, recruitment ended), Sweden (ongoing, recruitment ended), France (ongoing, recruitment ended), Netherlands (ongoing, recruitment ended).
Therapeutic area(s): Diseases [C] - Cardiovascular Diseases [C14]
Gender: Female, Male. Age: 18-64 years, 65+ years. Enrolment: 675.
Status: Ongoing, recruitment ended. Start date (EU): 2024-06-05. Decision date: 2024-05-22. Results received: No. Last updated: 2026-07-28.
Decision dates by country: SE: 2024-05-27, HU: 2024-05-23, DK: 2024-05-22, GR: 2024-05-23, DE: 2024-05-22, NL: 2024-05-27, ES: 2024-05-23, PL: 2024-05-27, BE: 2024-05-23, RO: 2024-05-27, IT: 2024-05-23, BG: 2024-05-28, SK: 2024-05-24, FR: 2024-05-23, CZ: 2024-05-23

Condition(s): Chronic kidney disease (CKD) and hypertension.
Product: Baxdrostat, Baxdrostat placebo, Baxdrostat, Forxiga 10 mg film-coated tablets

Primary endpoint: Change from baseline in eGFR to post treatment.
Endpoint(s): 1. Change from baseline in UACR., 2. Change from baseline in systolic BP (blood pressure)., 3. Kidney hierarchical composite endpoint.* *Defined as the most severe outcome of the following: 1. Death; 2. KFRT (chronic dialysis or kidney transplant); 3. Sustained GFR < 15 mL/min/1.73 m2; 4. Sustained GFR decline from baseline of ≥ 57%; 5 Sustained GFR decline from baseline of ≥ 50%; or 6. individual change from baseline to post-treatment eGFR if none of the outcomes occurred., 4. Change in eGFR from following randomisation., 5. Time to the first occurrence of any of the components of the composite of: 1) CV death 2) HF with and without hospitalisation 3) MI 4) Stroke

Source: https://euclinicaltrials.eu/ctis-public/view/2023-506457-38-00